EU clinical trial 2023-507596-22-00: GLOW-FISH: A phase Ib/II first-in-human imaging study of anti-GD2-800CW in patients with neuroblastoma.
Protocol code: SP_PS21DIN
Sponsor: Prinses Maxima Centrum voor Kinderoncologie B.V. (Hospital/Clinic/Other health care facility). Phase: Phase I and Phase II (Integrated)- First administration to humans. Countries: Netherlands (ongoing, recruiting).
Therapeutic area(s): Analytical,Diagnostic,Therapeutic Techniques and Equipment [E]-Surgical Procedures, Operative [E04]; Diseases [C] - Neoplasms [C04]
Gender: Female, Male. Age: 0-17 years. Enrolment: 22.
Status: Ongoing, recruiting. Start date (EU): 2025-11-05. Decision date: 2025-04-22. Results received: No. Last updated: 2025-10-17.

Condition(s): Neuroblastoma
Product: Anti-GD2-800CW

Primary endpoint: Anti-GD2-800CW related adverse events not to be expected from Dinutuximab-alone infusion, Tumor to background ratio (TBR) of at least 2.0 ex vivo and sufficient for detection during surgery. TBR is established by dividing the mean fluorescence signal of the tumor by the mean fluorescence signal of the background. Background is determined by fluorescence intensity in healthy kidney, liver and surrounding background tissue.
Endpoint(s): Pharmacokinetics of anti-GD2-800CW; blood samples will be taken at t=0 (just before infusion), t=8h (directly after infusion), t=24h (after infusion), t=72h (after infusion), t=96h (immediately before surgery), t=120h (24h after surgery), t=144h (48h after surgery) and t=192h (4 days after surgery)., The sensitivity and specificity of anti-GD2-800CW to detect GD2-expressing, vital tumor cells. Pathologic status of removed fluorescent tissue and of removed fluorescent tissue will be compared to fluorescent status., Clinical visibility: score of ≥ 4.0 on a Likert scale of 1-5 based on the judgement of three surgeons. They will grade the intra-operative visibility of the fluorescence and whether a clear distinction can be made on eyesight between tumor and surrounding tissue based on fluorescence.

Source: https://euclinicaltrials.eu/ctis-public/view/2023-507596-22-00